EU clinical trial 2022-502793-17-00: An Interventional, Prospective Open-Label Study of Immunosuppressive Therapies to Mitigate Immune-Mediated Loss of Therapeutic Response to Asfotase Alfa (STRENSIQ®) for Hypophosphatasia (RESTORE)
Protocol code: AA-HPP-407
Sponsor: Alexion Pharmaceuticals Inc. (Pharmaceutical company). Phase: Therapeutic use (Phase IV). Countries: France (ended).
Therapeutic area(s): Diseases [C] - Musculoskeletal Diseases [C05]
Gender: Female, Male. Age: 0-17 years. Enrolment: 1.
Status: Ended. End date (EU): 2025-08-08. End date: 2025-08-08. Decision date: 2024-01-18. Results received: No. Last updated: 2024-09-19.

Condition(s): HYPOPHOSPHATASIA
Product: IMMUNOGLOBULINS, NORMAL HUMAN, FOR INTRAVASCULAR ADM., Rixathon 500 mg concentrate for solution for infusion, Bortezomib Hikma 3,5 mg Pulver zur Herstellung einer Injektionslösung, Rixathon 100 mg concentrate for solution for infusion, MTX HEXAL 2,5 mg Tabletten, Methotrexat-GRY® 50 mg/2 ml Injektionslösung, ASFOTASE ALFA

Primary endpoint: Number and percentage of participants who achieve IST complete response at Week 100. The definition of IST complete response at Week 100 is defined as follows: ADA or NAb titer is decreased from Baseline by at least 2 titer steps or becomes negative, and Radiographic evidence of improvement on RSS by a score of at least 1 or more points from Baseline
Endpoint(s): ADA incidence, ADA response categories, ADA titer, NAb incidence and NAb titer in participants treated with IST undergoing asfotase alfa treatment through the duration of the study, Plasma concentrations of TNSALP as measured by asfotase alfa enzyme activity (PK), PLP, and PPi, at prespecified time points, Incidence of TEAEs and TESAEs, clinical safety laboratory test results, vital signs, 12-lead ECGs, physical examination findings, and for bortezomib treated participants echocardiography, and pediatric-modified Total Neuropathy Scale, Enumeration of CD19 B cells in participants treated with IST undergoing asfotase alfa treatment for the duration of the study

Source: https://euclinicaltrials.eu/ctis-public/view/2022-502793-17-00